EU clinical trial 2024-519004-27-00: A PHASE 1/2, OPEN-LABEL, EXPLORATORY CLINICAL TRIAL TO EVALUATE THE SAFETY AND EFFICACY OF DT-DEC01 THERAPY IN PATIENTS WITH DUCHENNE MUSCULAR DYSTROPHY
Protocol code: DT-DEC01-DMD-CT-1/2
Sponsor: Dystrogen Therapeutics Technology Polska Sp. z o.o. (Pharmaceutical company). Phase: Phase I and Phase II (Integrated)- First administration to humans. Countries: Poland (authorised, recruitment pending).
Therapeutic area(s): Diseases [C] - Musculoskeletal Diseases [C05]
Gender: Male. Age: 0-17 years. Enrolment: 20.
Status: Authorised, recruitment pending. Decision date: 2024-12-20. Results received: No. Last updated: 2026-04-24.

Condition(s): Duchenne Muscular Dystrophy
Product: DT-DEC01

Primary endpoint: Phase 1: The frequency of the incidence and severity of all adverse events – AEs, SAEs and AESI., Phase 1: Mean changes from the baseline (V0a) recorded in the functional assessments adjusted to the stage of the disease: for ambulatory patients: 6MWT, timed functions of NSAA: supine to rise and 10-meter walk/run, for non-ambulatory patients: PUL 2.0, at month 1 (V4), 3 (V5), 6 (V6), and 12 (V7)., Phase 1: Mean changes from the baseline (V0a) in the EMG assessment of MUP duration of the selected muscles of upper and lower extremity in both ambulatory and non-ambulatory patients, at month 3 (V5), 6 (V6), and 12 (V7)., Phase 2: The frequency of the incidence and severity of all adverse events – AEs, SAEs and AESI., Phase 2: Mean changes from the baseline (V0a) recorded in the functional assessments adjusted to the stage of the disease: a. for ambulatory patients: 6MWT, timed functions of NSAA: supine to rise and 10-meter walk/run b. for non-ambulatory patients: PUL 2.0 at month 1 (V4), 3 (V5), 6 (V6), and 12 (V7)., Phase 2: Mean changes from the baseline in the EMG assessment of MUP duration of the selected muscles of upper and lower extremity in both ambulatory and non-ambulatory patients at month 3, 6 and 12 .
Endpoint(s): Phase 2: Mean changes from the baseline (V0a) recorded by functional assessments (adjusted to the stage of the disease): for ambulatory patients: PUL 2.0, assessment of grip strength by dynamometer; for non-ambulatory patients: assessment of grip strength by dynamometer. At month 1 (V4), 3 (V5), 6 (V6), and 12 (V7)., Phase 2: Mean changes from the baseline (V0a) in QoL assessed by PODCI at month 1 (V4), 3 (V5), 6 (V6), and 12 (V7)., Phase 2: Evaluation of Overall Treatment Effect at month 1 (V4), 3 (V5), 6 (V6), and 12 (V7).

Source: https://euclinicaltrials.eu/ctis-public/view/2024-519004-27-00